EU clinical trial 2024-518524-69-00: A Phase I Randomised Double-Blind Placebo Controlled Safety Study of Intramyocardial Injection of CLXR-001 in Patients Undergoing Coronary Artery Bypass Graft (CABG) Surgery
Protocol code: CLX003-IMP-1-260420
Sponsor: Cell Therapy Limited (Pharmaceutical company). Phase: Human Pharmacology (Phase I)- First administration to humans. Countries: Hungary (ended).
Therapeutic area(s): Diseases [C] - Cardiovascular Diseases [C14]
Gender: Female, Male. Age: 18-64 years, 65+ years. Enrolment: 10.
Status: Ended. Start date (EU): 2021-07-30. End date (EU): 2025-12-31. End date: 2026-01-01. Decision date: 2024-12-03. Results received: No. Last updated: 2025-04-11.

Condition(s): Ischaemic cardiomyopathy

Source: https://euclinicaltrials.eu/ctis-public/view/2024-518524-69-00